EU clinical trial 2024-516760-28-00: A study to compare Onivyde manufactured at two different production sites in adult participants with advanced cancer in the pancreas
Protocol code: D-FR-60010-015
Sponsor: Ipsen Pharma (Pharmaceutical company). Phase: Human Pharmacology (Phase I)- Bioequivalence Study. Countries: Spain (ended), Hungary (ended), Italy (ended), France (ended).
Therapeutic area(s): Diseases [C] - Neoplasms [C04]
Gender: Female, Male. Age: 18-64 years, 65+ years. Enrolment: 120.
Status: Ended. Start date (EU): 2022-05-04. End date (EU): 2025-04-15. End date: 2025-04-16. Decision date: 2024-10-14. Results received: No. Last updated: 2025-02-20.
Decision dates by country: FR: 2024-10-17, HU: 2024-10-14, IT: 2024-11-11, ES: 2024-10-14

Condition(s): Metastatic Pancreatic Adenocarcinoma

Source: https://euclinicaltrials.eu/ctis-public/view/2024-516760-28-00